EU clinical trial 2025-523017-28-00: A Phase 3 Multicenter, Randomized, Open-label Study of ASP-1929 Photoimmunotherapy in Combination With Pembrolizumab Versus Standard of Care in the First-line Treatment of Patients With Locoregional Recurrence of Squamous Cell Carcinoma of the Head and Neck (HNSCC) With No Distant Metastases
Protocol code: ASP-1929-381
Sponsor: Rakuten Medical Inc. (Pharmaceutical company). Phase: Therapeutic confirmatory (Phase III). Countries: Poland (authorised, recruitment pending).
Therapeutic area(s): Diseases [C] - Neoplasms [C04]
Gender: Female, Male. Age: 18-64 years, 65+ years. Enrolment: 30.
Status: Authorised, recruitment pending. Decision date: 2026-04-03. Results received: No. Last updated: 2026-04-15.
Decision dates by country: PL: 2026-04-15

Condition(s): Locoregional Recurrence of Squamous Cell Carcinoma of the Head and Neck (HNSCC)
Product: Docetaxel Hikma 80 mg/4 ml Konzentrat zur Herstellung einer Infusionslösung, 5-FU medac 50 mg/ml, Injektionslösung, Carboplatin Hikma 10 mg/ml Konzentrat zur Herstellung einer Infusionslösung, Paclitaxel Ribosepharm 6 mg/ml Konzentrat zur Herstellung einer Infusionslösung, ASP-1929, Cisplatinum Accord, 1 mg/ml, koncentrat do sporządzania roztworu do infuzji., KEYTRUDA 25 mg/mL concentrate for solution for infusion.

Primary endpoint: Overall Survival (OS): OS is defined as the time from randomisation to death from any cause.
Endpoint(s): Key Secondary: • Complete Response Rate: CRR is defined as the proportion of patients with best overall response of confirmed CR per modified RECIST 1.1 as assessed by central reviewer. • Objective Response Rate: ORR is defined as the proportion of patients with best overall response of confirmed CR or confirmed PR per modified RECIST 1.1 as assessed by central reviewer.

Source: https://euclinicaltrials.eu/ctis-public/view/2025-523017-28-00